EU clinical trial 2024-511620-13-00: Subcutaneous Injections of Sodium Thiosulfate for ectopic calcifications or ossifications. A pilot study.
Protocol code: I17004
Sponsor: Centre Hospitalier Et Universitaire De Limoges (Hospital/Clinic/Other health care facility). Phase: Therapeutic exploratory (Phase II). Countries: France (ongoing, recruiting).
Therapeutic area(s): Diseases [C] - Skin and Connective Tissue Diseases [C17]
Gender: Female, Male. Age: 0-17 years, 18-64 years. Enrolment: 40.
Status: Ongoing, recruiting. Start date (EU): 2020-06-05. Decision date: 2024-03-22. Results received: No. Last updated: 2026-07-08.
Decision dates by country: FR: 2024-05-30

Condition(s): Patient presenting with: - ectopic ossification secondary to iPPSD2 or - ectopic calcification secondary to dermatomyositis or - ectopic calcification secondary to systemic sclerosis
Product: Natriumthiosulfat 10%

Primary endpoint: Percentage of volume evolution of the treated calcifications / ossifications between the beginning (M6) and the end (M12) of STS treatment, in each of the three diseases (dermatomyositis, systemic sclerosis and iPPSD2), evaluated on CT-scan measurements
Endpoint(s): Volume of the treated calcifications / ossifications at (i) inclusion (M0), the end of the run-in period (M6) and after 6 months of local injections of STS (M12) in each disease, evaluated on CT-scan measurements, (i) Adverse events (clinical and biological): causality, severity, and seriousness (outcome, drug discontinuation or drug reduction due to AE) during the 6 months of STS treatment. (ii) Trabecular bone density calculated through measurements of Hounsfield units level within the bone facing the treated area on M0, M6 and M12 CT evaluations. (iii) pain associated with STS infusion or injections, Hounsfield density of the treated ectopic calcifications/ossifications at (i) inclusion (M0), the end of the run-in period (M6) and after 6 months of local injections of STS (M12), evaluated on CT-scan measurements, Percentage of patients with a clinically pertinent variation in pain evaluated with pain scales:, difference in HEDEN ≥ 2 (2-7 years old), difference in VAS score ≥ 2 (> 7 years old) between M0-M6 and M6-M12., Percentage of patients with a clinically pertinent variation in quality of life evaluated with quality of life scales: difference in PedsQL scale ≥ 5 (2 years old -18 years old, using appropriates reports), difference in SF36 score ≥ 20 (> 18 years old) between M0-M6 and M6-M12

Source: https://euclinicaltrials.eu/ctis-public/view/2024-511620-13-00